EU clinical trial 2022-501451-87-00: A Phase Ib/II, Multi-Center, Open-Label Study to Evaluate the Safety/Tolerability, Pharmacokinetics, and Efficacy of GFH925 in Combination with Cetuximab in Previously Untreated Advanced NSCLC Harboring KRAS G12C Mutation
Protocol code: GFH925X0201
Sponsor: Zhejiang Genfleet Therapeutics Co. Ltd. (Pharmaceutical company). Phase: Phase I and Phase II (Integrated)- Other. Countries: Italy (ended), Spain (ended), France (not authorised), Greece (ended).
Therapeutic area(s): Diseases [C] - Neoplasms [C04]
Gender: Female, Male. Age: 18-64 years, 65+ years. Enrolment: 32.
Status: Ended. Start date (EU): 2023-03-31. End date (EU): 2025-04-29. End date: 2025-05-01. Decision date: 2023-02-23. Results received: Yes. Last updated: 2025-04-11.
Decision dates by country: ES: 2023-04-27, IT: 2023-02-23, GR: 2023-06-20

Condition(s): Previously Untreated Advanced NSCLC Harboring KRAS G12C Mutation
Product: Erbitux 5 mg/mL solution for infusion, Fulzerasib

Primary endpoint: Incidence of adverse events (AEs), serious adverse events (SAEs). Changes in laboratory parameters, vital signs, physical examinations, and electrocardiogram (ECG), Overall response rate (ORR)
Endpoint(s): Plasma concentration of GFH925, PK parameters of GFH925 including but not limited to Cmax, Tmax, Area under the curve (AUC)0-last, AUC0-inf, T1/2, CL/F and Vd/F post the first dosing, PK parameters of GFH925 including but not limited to Ctrough, Cmax,ss, Cmin,ss, Tmax,ss, AUCtau,ss, T1/2,ss, CL/Fss Vd/Fss and Racc at steady state, Best overall response (BOR), duration of response (DoR), time to response (TTR), progression free survival (PFS) evaluated per Response Evaluation Criteria in Solid Tumor (RECIST) 1.1, and overall survival (OS), Disease control rate (DCR), duration of response (DoR), time to response (TTR), progression free survival (PFS), and overall survival (OS), Incidence of AEs and SAEs. Changes in laboratory parameters, vital signs, physical examinations, and ECG, Ctrough of GFH925 and the concentration of GFH925 at the time near Tmax

Source: https://euclinicaltrials.eu/ctis-public/view/2022-501451-87-00